EU clinical trial 2022-501419-15-00: A Phase 3, Randomized, Double-Blind, Double-Dummy, Parallel Group, Active-Controlled Study to Evaluate the Efficacy and Safety of Milvexian, an Oral Factor XIa Inhibitor, Versus Apixaban in Participants with Atrial Fibrillation
Protocol code: 70033093AFL3002
Sponsor: Janssen - Cilag International (Pharmaceutical company). Phase: Therapeutic confirmatory (Phase III). Countries: Spain (ongoing, recruitment ended), Germany (ongoing, recruitment ended), Slovakia (ongoing, recruitment ended), Bulgaria (ongoing, recruitment ended), Greece (ongoing, recruitment ended), Portugal (ongoing, recruitment ended), Hungary (ongoing, recruitment ended), Netherlands (ongoing, recruitment ended), Denmark (ongoing, recruitment ended), Lithuania (ongoing, recruitment ended), Poland (ongoing, recruitment ended), Romania (ongoing, recruitment ended), Italy (ongoing, recruitment ended), Croatia (ongoing, recruitment ended), Estonia (ongoing, recruitment ended), Belgium (ongoing, recruitment ended), Czechia (ongoing, recruitment ended), Latvia (ongoing, recruitment ended), France (ongoing, recruitment ended).
Therapeutic area(s): Diseases [C] - Cardiovascular Diseases [C14]
Gender: Female, Male. Age: 18-64 years, 65+ years. Enrolment: 6819.
Status: Ongoing, recruitment ended. Start date (EU): 2023-08-23. Decision date: 2023-08-07. Results received: No. Last updated: 2026-06-24.
Decision dates by country: EE: 2023-08-07, LV: 2023-08-10, GR: 2023-08-07, FR: 2023-08-11, DE: 2023-08-10, IT: 2023-08-10, NL: 2023-08-10, ES: 2023-08-09, PT: 2023-08-08, BE: 2023-08-07, BG: 2023-08-14, HR: 2023-08-11, CZ: 2023-08-16, LT: 2023-08-09, SK: 2023-08-07, HU: 2023-08-10, PL: 2023-08-14, RO: 2023-08-10, DK: 2023-08-07

Condition(s): Atrial Fibrillation
Product: Eliquis 5 mg film-coated tablets, Eliquis 5 mg film-coated tablets, Eliquis 5 mg film-coated tablets, Apixaban matching placebo, JNJ-70033093, Eliquis 2.5 mg film-coated tablets, Ondexxya 200 mg powder for solution for infusion, Eliquis 2.5 mg film-coated tablets, Milvexian matching placebo, Eliquis 2.5 mg film-coated tablets

Primary endpoint: Time to the first occurrence of composite endpoint of stroke and non-CNS systemic embolism
Endpoint(s): • Time to the first occurrence of ISTH major bleeding • Time to the first occurrence of the composite of ISTH major and CRNM bleeding, Time to the first occurrence of composite endpoint of stroke, non-CNS systemic embolism, and ISTH major bleeding., Time to the first occurrence of composite endpoint of CV death, MI, stroke, and non-CNS systemic embolism., Time to CV death, Time to the first occurrence of composite endpoint of all-cause death, MI, stroke and non-CNS systemic embolism., Time to the first occurrence of composite endpoint of CV death, MI, stroke, acute limb ischemia (ALI [any unanticipated revascularization or amputation of ischemic limb]), and urgent hospitalization for vascular cause of ischemic nature (including DVT and PE).

Source: https://euclinicaltrials.eu/ctis-public/view/2022-501419-15-00